EU clinical trial 2024-517614-14-00: A Phase 2b, Multi-center, Randomized, Double-blind, Placebo controlled Study of IMVT-1402 Treatment in Adult Participants with Chronic Inflammatory Demyelinating Polyneuropathy (CIDP)
Protocol code: IMVT-1402-2401
Sponsor: Immunovant Sciences GmbH (Pharmaceutical company). Phase: Therapeutic exploratory (Phase II). Countries: Austria (authorised, recruiting), Hungary (authorised, recruitment pending), Slovenia (authorised, recruiting), Greece (ongoing, recruiting), Denmark (ongoing, recruiting), Ireland (authorised, recruitment pending), Finland (ongoing, recruiting), Estonia (ongoing, recruiting), Spain (ongoing, recruiting), Slovakia (ongoing, recruiting), Netherlands (ongoing, recruiting), Poland (ongoing, recruiting), Norway (ongoing, recruiting), Italy (ongoing, recruiting), Portugal (ongoing, recruiting), Belgium (ongoing, recruiting), Germany (authorised, recruiting), Romania (ongoing, recruiting), Bulgaria (ongoing, recruiting).
Therapeutic area(s): Diseases [C] - Immune System Diseases [C20]
Gender: Female, Male. Age: 18-64 years, 65+ years. Enrolment: 79.
Start date (EU): 2025-11-28. Decision date: 2025-10-28. Results received: No. Last updated: 2026-07-07.
Decision dates by country: NO: 2025-11-03, SK: 2025-10-29, PL: 2025-10-31, BG: 2025-11-03, DE: 2025-10-29, ES: 2025-10-31, PT: 2025-10-28, RO: 2025-11-13, HU: 2025-10-29, NL: 2025-11-03, SI: 2025-10-29, BE: 2025-11-13, EE: 2025-10-31, GR: 2025-10-30, AT: 2025-11-03, IT: 2025-10-28, FI: 2025-10-29, DK: 2025-10-28, IE: 2025-10-31

Condition(s): Chronic Inflammatory Demyelinating Polyneuropathy (CIDP)
Product: IMVT-1402, Placebo is identical to IMP but with no active substance.

Primary endpoint: The proportion of participants remaining Relapse-free by Week 24.
Endpoint(s): Change from baseline to Week 24 in I-RODS., Change from baseline to Week 24 in Mean Grip Strength in the dominant hand., Change from baseline to Week 24 in MRC-SS., Change from baseline to Week 24 in aINCAT score.

Source: https://euclinicaltrials.eu/ctis-public/view/2024-517614-14-00